EU clinical trial 2023-507425-42-00: A Prospective, Randomized, Placebo-controlled Clinical Trial of oral vancomycin in adults and young adults (15-17 years old) affected by Primary Sclerosing Cholangitis with or without Inflammatory Bowel Disease
Protocol code: VanC-IT
Sponsor: University Of Milano Bicocca (Educational Institution). Phase: Therapeutic exploratory (Phase II). Countries: Italy (ongoing, recruiting).
Therapeutic area(s): Diseases [C] - Digestive System Diseases [C06]
Gender: Female, Male. Age: 0-17 years, 18-64 years, 65+ years. Enrolment: 84.
Status: Ongoing, recruiting. Start date (EU): 2023-06-15. Decision date: 2023-12-22. Results received: No. Last updated: 2026-05-12.

Condition(s): Primary Sclerosing Cholangitis
Product: VANCOMYCIN, Placebo capsules contain the only excipient present in the formulation, Polyethylene glycol 6000; the active ingredient is substituted by the same excipient to obtain the intended filling weight. The pharmaceutical form is white/white 00 hard gelatin capsules for oral administration.

Primary endpoint: ALP levels at 6 months
Endpoint(s): reduction of ALP levels =40% (for those of 15-17-year-old the liver isoenzyme will be evaluated), safety and tolerability: adverse events, clinical hematology, clinical chemistry, urinalysis, single 12-lead electrocardiograms (ECGs), vital sign measurements including body weight, systolic and diastolic blood pressure (BP), body temperature and pulse rate. Rectal swab to exclude infection or colonisation with vancomycinresistant enterococci (VRE), reduction of serum gammaglutamyltransferase (GGT) levels, reduction of serum aspartate-aminotransferase (AST) and Alanine-aminotransferase (ALT) levels, normalization of serum bilirubin levels, change in Amsterdam-Oxford prognostic score, change in the Revised PSC Mayo Risk Score, lack of progression in LSM at FibroScan (change in liver stiffness <= 1.3 kPa), lack of progression in bile duct strictures and dilatation (evaluated at MCRP using traditional semiquantitative scoring such as Anali criteria), change in non-invasive biomarkers of liver fibrosis (ELF, PRO-C3, PRO-C5; C3M, C4M and BGM), cell apoptosis and necrosis (CK18 M30 and M65), cytokines (TGF-ß, IL-4, IL- 13, IL-10, etc.) peripheral blood mononuclear cells (Th1 and Th17 subsets), and biomarkers of FXR activity (FGF-19, C4 and bile acid), changes in IBD activity indexes: Crohn's Disease Activity Index [CDAI] score and partial Mayo score [pMCS], for Crohn’s disease [CD] and UC respectively; changes in Creactive protein (CRP) and fecal calprotectin levels; changes in Simple Endoscopic Score for Crohn’s Disease [SES-CD] and endoscopic Mayo score, for CD and UC respectively; changes in Nancy Histological Index for UC and Global Histologic Disease Activity Score [GHAS] for CD, proportion of patients who are in clinical remission (defined as CDAI<150 for CD or partial Mayo Score <2 for UC) at baseline, week 4, 12 and 24. and week 12 of follow up; proportion of patients achieving endoscopic remission (defined as SES-CD = 2 for CD or endoscopic Mayo score <1 for UC) at baseline and week 24; proportion of patients achieving histologic healing (as defined as GHAS =4 for CD or Nancy Histological Index <1 for UC) at baseline and week 24, changes in ultrasound activity indices (lesion length, bowel wall thickness, color Doppler signals, bowel wall stratification, inflammatory mesenteric fat, and intestinal complications) at week 24, changes in health-related quality of life: visual analogue scale (VAS) score for itch, Chronic Liver Disease Questionnaire (CLDQ), EQ-5D-5L questionnaire, PSC patient reported outcome (PSC-PRO) questionnaire, Inflammatory Bowel Disease Questionnaire (IBDQ)

Source: https://euclinicaltrials.eu/ctis-public/view/2023-507425-42-00